EU clinical trial 2025-524690-16-00: Open-label study of BBO-11818 in adult subjects with KRAS mutant cancer
Protocol code: TBBO11818-101
Sponsor: Theras Inc. (Pharmaceutical company). Phase: Human Pharmacology (Phase I)- First administration to humans. Countries: Spain (authorised, recruiting), Italy (authorised, recruiting), France (authorised, recruiting).
Therapeutic area(s): Diseases [C] - Neoplasms [C04]
Gender: Female, Male. Age: 18-64 years, 65+ years. Enrolment: 2999997.
Status: Authorised, recruiting. Start date (EU): 2026-07-03. Decision date: 2026-06-16. Results received: No. Last updated: 2026-06-24.
Decision dates by country: FR: 2026-06-18, ES: 2026-06-22, IT: 2026-06-16

Condition(s): Solid Tumors

Source: https://euclinicaltrials.eu/ctis-public/view/2025-524690-16-00